EU clinical trial 2024-516042-18-00: Preoperative intraperitoneal chemotherapy in adjuvant hyperthermia adjunctive therapy in advanced gastric cancer with high-risk of peritoneal recurrence - a multicentre randomized trial.
Protocol code: GastricCHIMERAtrial
Sponsor: Uniwersytet Jagiellonski Collegium Medicum (Educational Institution). Phase: Phase II and Phase III (Integrated). Countries: Poland (ended).
Therapeutic area(s): Diseases [C] - Neoplasms [C04]
Gender: Female, Male. Age: 18-64 years, 65+ years. Enrolment: 182.
Status: Ended. Start date (EU): 2021-09-08. End date (EU): 2025-01-28. Decision date: 2024-09-06. Results received: Yes. Last updated: 2024-09-06.

Condition(s): Gastric Carcinoma
Product: IRINOTECAN

Primary endpoint: Peritoneal recurrence rate, Recurrence rates, Quality of life assessment by means of QLQ-C30 and STO22 questionaries
Endpoint(s): Overall survival, Disease free survival, Ocena parametrów jakości życia przy użyciu kwestionariusza QLQC30 oraz STO22

Source: https://euclinicaltrials.eu/ctis-public/view/2024-516042-18-00